EU clinical trial 2024-515753-16-00: Safety and Efficacy of multiple doses of the PAINLESS Nerve Growth Factor CHF6467 in paediatric subjects with Optic Pathway Glioma (OPG). A randomized clinical trial (RCT)
Protocol code: CHF6467-OPG
Sponsor: Fondazione Policlinico Universitario Agostino Gemelli IRCCS (Hospital/Clinic/Other health care facility). Phase: Phase I and Phase II (Integrated)- Other. Countries: Italy (ongoing, recruitment ended).
Therapeutic area(s): Diseases [C] - Eye Diseases [C11]
Gender: Female, Male. Age: 0-17 years, 18-64 years. Enrolment: 36.
Status: Ongoing, recruitment ended. Start date (EU): 2023-05-18. Decision date: 2024-11-05. Results received: No. Last updated: 2026-03-23.
Decision dates by country: IT: 2025-01-16

Condition(s): Optic Pathway Glioma (OPG)
Product: The Placebo composition is the same of the IMP except the active ingredient

Primary endpoint: The largest radius of the field of viewmeasured in degrees visual angle by kinetic perimetry according to Goldmann with the aim V/4e

Source: https://euclinicaltrials.eu/ctis-public/view/2024-515753-16-00